EU clinical trial 2024-518895-30-00: A Phase 2 Study of Mutant-selective PI3Kα Inhibitor, RLY-2608, in Adults and Children with PIK3CA Related Overgrowth Spectrum and Malformations Driven by PIK3CA Mutation
Protocol code: RLY-2608-201
Sponsor: Relay Therapeutics Inc. (Pharmaceutical company). Phase: Therapeutic exploratory (Phase II). Countries: Belgium (ongoing, recruiting), Spain (ongoing, recruiting), Italy (ongoing, recruiting), France (authorised, recruiting), Germany (authorised, recruiting), Ireland (authorised, recruiting), Norway (authorised, recruitment pending).
Therapeutic area(s): Diseases [C] - Congenital, Hereditary, and Neonatal Diseases and Abnormalities [C16]
Gender: Female, Male. Age: 0-17 years, 18-64 years, 65+ years. Enrolment: 99.
Start date (EU): 2025-11-21. Decision date: 2025-05-14. Results received: No. Last updated: 2026-07-02.
Decision dates by country: BE: 2025-05-15, IE: 2026-01-23, FR: 2026-05-11, NO: 2026-01-20, ES: 2025-05-14, IT: 2025-05-20, DE: 2026-01-12

Condition(s): PIK3CA Related Overgrowth Spectrum and Malformations Driven by PIK3CA Mutation
Product: RLY-2608, RLY-2608

Primary endpoint: Parts 1 and 2: RP2D(s) for Groups 1, 2, and 3, Parts 1 and 2: Overall safety profile of RLY-2608 as assessed by the type, frequency, severity, timing, and relationship to RLY-2608 of any DLT, AEs, serious adverse events (SAEs), changes in vital signs, ECGs, and safety laboratory tests, Part 3: Percentage of participants with volumetric response at Week 24
Endpoint(s): Parts 1 and 2: Percentage of participants with volumetric response at Weeks 12 and 24, Parts 1 and 2: Percent change from baseline in lesion volume by blinded independent central review (BICR), Parts 1 and 2: Duration of response, defined as the time of first documented response to the date of first documented disease progression or death due to any cause, Parts 1 and 2: Plasma concentrations and PK parameters, including area under the concentration-time curve (AUC), Cmax, tmax, terminal half-life (t1/2), total body clearance following oral dose (CL/F), and other relevant PK parameters for RLY-2608, Part 3: Percentage of participants with improvement compared to baseline based on PGI-S, PGI-C and IGIC of RLY-2608 compared to placebo, Part 3: Change from baseline by age-appropriate PROMIS Profile, Part 3: Change from baseline in EQ-5D, EQ-5D-Y, or EQ-5D-Y Proxy, Part 3: Percent change from baseline in lesion volume by BICR, Part 3: Duration of response, defined as the time of first documented response to the date of first documented disease progression by BICR or death due to any cause, Part 3: Overall safety profile of RLY-2608 as assessed by the type, frequency, severity, timing, and relationship to RLY-2608 of any DLT; AE; SAE; or change in vital signs, ECGs, and safety laboratory test

Source: https://euclinicaltrials.eu/ctis-public/view/2024-518895-30-00